EU clinical trial 2023-507555-29-00: C5731004 - SGNDV-004 - A Phase 1b/2 Open-Label Study of Disitamab Vedotin in Combination with Other Anticancer Therapies in Solid Tumors
Protocol code: C5731004 - SGNDV-004
Sponsor: Seagen Inc. (Pharmaceutical company). Phase: Phase I and Phase II (Integrated)- Other. Countries: Italy (ongoing, recruitment ended), Germany (ongoing, recruitment ended), Spain (ongoing, recruitment ended), France (not authorised).
Therapeutic area(s): Diseases [C] - Neoplasms [C04]
Gender: Female, Male. Age: 18-64 years, 65+ years. Enrolment: 68.
Start date (EU): 2024-08-16. Decision date: 2024-06-10. Results received: No. Last updated: 2026-05-26.
Decision dates by country: FR: 2024-06-17, DE: 2024-06-14, IT: 2024-06-12, ES: 2024-06-10

Condition(s): LA/mGC/GEJC (locally advanced unresectable or metastatic gastric cancer and gastroesophageal junction adenocarcinoma, collectively) and LA/mBC (locally advanced metastatic breast cancer)
Product: TUKYSA 50 mg film-coated tablets, TUKYSA 150 mg film-coated tablets, Disitamab Vedotin

Primary endpoint: Incidence of dose-limiting toxicities (DLTs) in dose escalation phase, Type, incidence, severity, seriousness, and relatedness of AEs, Type, incidence, and severity of laboratory abnormalities as well as significant changes from baseline, Frequency of treatment interruptions, dose reductions, and treatment discontinuations due to AEs, ORR (confirmed complete response [CR] and confirmed partial response [PR]) per Response Evaluation Criteria in Solid Tumors version 1.1 (RECIST v1.1) by investigator assessment
Endpoint(s): Duration of response (DOR) per RECIST v1.1 by investigator assessment, Disease control rate (DCR) (confirmed CR, confirmed PR, and stable disease) per RECIST v1.1 by investigator assessment, Progression-free survival (PFS) per RECIST v1.1 by investigator assessment, Overall Survival (OS), Estimates of selected PK parameters of disitamab vedotin, total antibody, and unconjugated MMAE, Incidence of anti-drug antibodies (ADA) against disitamab vedotin

Source: https://euclinicaltrials.eu/ctis-public/view/2023-507555-29-00